EU clinical trial 2025-520988-41-00: Open-label, Uncontrolled, Multicenter Trial to Evaluate the Pharmacokinetics, Pharmacodynamics, Safety, and Tolerability of Inebilizumab in Children From 2 Years to Less Than 18 Years of Age with Immunoglobulin G4 related Disease (IgG4-RD)
Protocol code: 20240202
Sponsor: Amgen Inc. (Pharmaceutical company). Phase: Therapeutic exploratory (Phase II). Countries: Greece (authorised, recruiting), Poland (authorised, recruitment pending), Italy (authorised, recruiting), Spain (authorised, recruiting).
Therapeutic area(s): Diseases [C] - Immune System Diseases [C20]
Gender: Female, Male. Age: 0-17 years. Enrolment: 7.
Start date (EU): 2026-05-15. Decision date: 2026-02-25. Results received: No. Last updated: 2026-07-03.
Decision dates by country: GR: 2026-02-25, IT: 2026-03-05, PL: 2026-03-07, ES: 2026-03-04

Condition(s): Immunoglobulin G4 related Disease (IgG4-RD)
Product: Uplizna 100 mg concentrate for solution for infusion

Primary endpoint: • PK parameters, including maximum plasma concentration (Cmax), area under the plasma concentration-time curve (AUC), terminal half-life (t½), clearance (CL), and volume of distribution at steady-state (Vss), • Change from baseline in CD20+ B cell counts, • Incidence of adverse events, serious adverse events, events of interest (EOIs), and change from baseline in laboratory parameters and vital signs
Endpoint(s): • Disease activity endpoints include: - Time-to-first treated flare across 52 weeks - Proportion of flare-free participants across 52 weeks - Annualized flare rate across 52 weeks, • Presence of antidrug antibodies (ADA) before and after initiation of treatment, • Percent reduction from baseline in daily glucocorticoid dose at week 52 taken for the purpose of IgG4 RD control

Source: https://euclinicaltrials.eu/ctis-public/view/2025-520988-41-00